EU clinical trial 2023-506495-27-00: A Phase 1 study of JNJ-87704916, a tumor-targeting virus, injected into tumor for advanced cancer
Protocol code: 87704916LUC1001
Sponsor: Johnson And Johnson Enterprise Innovation Inc. (Pharmaceutical company). Phase: Human Pharmacology (Phase I)- First administration to humans. Countries: Spain (ongoing, recruiting), France (ongoing, recruiting).
Therapeutic area(s): Diseases [C] - Neoplasms [C04]
Gender: Female, Male. Age: 18-64 years, 65+ years. Enrolment: 50.
Status: Ongoing, recruiting. Start date (EU): 2024-06-18. Decision date: 2024-03-25. Results received: No. Last updated: 2026-05-27.
Decision dates by country: ES: 2024-03-25, FR: 2024-03-28

Condition(s): Advanced solid tumors

Source: https://euclinicaltrials.eu/ctis-public/view/2023-506495-27-00